EU clinical trial 2023-509600-15-00: Efficacy and safety of co-administered cagrilintide and semaglutide (CagriSema) 1.0 mg/1.0 mg s.c. once weekly versus tirzepatide 5 mg s.c. once weekly in participants with type 2 diabetes inadequately controlled on metformin, SGLT2 inhibitor or both
Protocol code: NN9388-7741
Sponsor: Novo Nordisk A/S (Pharmaceutical company). Phase: Therapeutic confirmatory (Phase III). Countries: Romania (ended), Hungary (ended), Spain (ended), Germany (ended), Greece (ended), Poland (ended).
Therapeutic area(s): Diseases [C] - Nutritional and Metabolic Diseases [C18]
Gender: Female, Male. Age: 18-64 years, 65+ years. Enrolment: 410.
Status: Ended. Start date (EU): 2024-10-18. End date (EU): 2026-07-09. End date: 2026-07-10. Decision date: 2024-08-20. Results received: No. Last updated: 2026-08-03.
Decision dates by country: PL: 2024-08-26, RO: 2024-08-26, GR: 2024-08-22, HU: 2024-08-26, ES: 2024-08-20, DE: 2024-08-20

Condition(s): Type 2 Diabetes
Product: cagrilintide semaglutide, Mounjaro 5 mg solution for injection in pre-filled pen, Mounjaro 2.5 mg solution for injection in pre-filled pen, cagrilintide semaglutide, cagrilintide semaglutide

Primary endpoint: Change in HbA1c from baseline (week 0) to end of treatment (week 60), Relative change in body weight from baseline (week 0) to end of treatment (week 60)
Endpoint(s): Superiority of CagriSema 00 mg/00 mg versus tirzepatide 5 mg: Change in HbA1c from baseline (week 0) to end of treatment (week 60), Effect of CagriSema 00 mg/00 mg versus tirzepatide 5 mg: Change in FPG from baseline (week 0) to end of treatment (week 60), Effect of CagriSema 00 mg/00 mg versus tirzepatide 5 mg: Achievement of HbA1c target values of ≤6.5% (≤48 mmol/mol) at the end of treatment (week 60), Effect of CagriSema 00 mg/00 mg versus tirzepatide 5 mg: Achievement of HbA1c target values of <7.0% (<53 mmol/mol) at the end of treatment (week 60), Effect of CagriSema 00 mg/00 mg versus tirzepatide 5 mg: Achievement of ≥ 10% weight reduction from baseline (week 0) to end of treatment (week 60), Effect of CagriSema 00 mg/00 mg versus tirzepatide 5 mg: Achievement of ≥ 5% weight reduction from baseline (week 0) to end of treatment (week 60), Effect of CagriSema 00 mg/00 mg versus tirzepatide 5 mg: Achievement of ≥ 15% weight reduction from baseline (week 0) to end of treatment (week 60), Effect of CagriSema 00 mg/00 mg versus tirzepatide 5 mg: Achievement of ≥ 20% weight reduction from baseline (week 0) to end of treatment (week 60), Effect of CagriSema 00 mg/00 mg versus tirzepatide 5 mg: Change in systolic blood pressure from baseline (week 0) to end of treatment (week 60), Effect of CagriSema 00 mg/00 mg versus tirzepatide 5 mg: Change in diastolic blood pressure from baseline (week 0) to end of treatment (week 60), Effect of CagriSema 00 mg/00 mg versus tirzepatide 5 mg: Change in waist circumference from baseline (week 0) to end of treatment (week 60), Effect of CagriSema 00 mg/00 mg versus tirzepatide 5 mg: Ratio to baseline in lipids from baseline (week 0) to end of treatment (week 60): • Total cholesterol • HDL cholesterol • LDL cholesterol • VLDL cholesterol • Triglycerides • Non-HDL cholesterol, Effect of CagriSema 00 mg/00 mg versus tirzepatide 5 mg: Change in SF-36v2 score from baseline (week 0) to end of treatment (week 60): • Physical Component Summary score • Mental Component Summary score • Vitality subscale, Effect of CagriSema 00 mg/00 mg versus tirzepatide 5 mg: Change in IWQOL-Lite-CT from baseline (week 0) to end of treatment (week 60): • Physical Function score • Total score, Safety and tolerability of CagriSema 00 mg/00 mg versus tirzepatide 5 mg: Number of TEAEs from baseline (week 0) to end of treatment (week 60), Safety and tolerability of CagriSema 00 mg/00 mg versus tirzepatide 5 mg: Number of clinically significant hypoglycaemic episodes (level 2) (<3.0 mmol/L (<54 mg/dL), confirmed by BG meter) from baseline (week 0) to end of treatment (week 60), Safety and tolerability of CagriSema 00 mg/00 mg versus tirzepatide 5 mg: Number of severe hypoglycaemic episodes (level 3): hypoglycaemia associated with severe cognitive impairment requiring external assistance for recovery, with no specific glucose threshold from baseline (week 0) to end of treatment (week 60)

Source: https://euclinicaltrials.eu/ctis-public/view/2023-509600-15-00